EU clinical trial 2022-502791-22-01: A Phase 3, Randomized, Double-blind, Active Comparator-controlled Clinical Study to Evaluate the Safety, Tolerability, and Immunogenicity of V116 in Pneumococcal Vaccine-naïve Adults 18 to 64 years of Age With Increased Risk for Pneumococcal Disease
Protocol code: V116-008
Sponsor: Merck Sharp & Dohme LLC (Pharmaceutical company). Phase: Therapeutic confirmatory (Phase III). Countries: Poland (ended).
Therapeutic area(s): Diseases [C] - Bacterial Infections and Mycoses [C01]
Gender: Female, Male. Age: 18-64 years. Enrolment: 100.
Status: Ended. Start date (EU): 2023-05-17. End date (EU): 2024-02-06. End date: 2024-02-16. Decision date: 2023-04-11. Results received: Yes. Last updated: 2024-02-29.

Condition(s): Pneumococcal infection
Product: PNEUMOCOCCUS, PURIFIED POLYSACCHARIDES ANTIGEN CONJUGATED, Sodium Chloride Intravenous Infusion BP 0.9% w/v, Pneumococcal 21-valent Conjugate Vaccine, PNEUMOCOCCUS, PURIFIED POLYSACCHARIDES ANTIGEN

Primary endpoint: Percentage of participants with solicited injection-site adverse events (AEs) from Day 1 through Day 5 postvaccination, Percentage of participants with solicited systemic AEs from Day 1 through Day 5 postvaccination, Percentage of participants with vaccine-related serious adverse events (SAEs) from Day 1 through the duration of participation in the study, Serotype-specific OPA GMTs postvaccination with V116 (30 days postvaccination [Day 30]) or PCV15 + PPSV23 (30 days postvaccination with the final dose in the regimen [Week 12])
Endpoint(s): Serotype-specific Immunoglobulin G (IgG) geometric mean concentrations (GMCs) postvaccination with V116 (Day 30) and PCV15 + PPSV23 (Week 12), Serotype-specific geometric mean fold rises (GMFRs) from baseline (Day 1) to postvaccination with V116 (Day 30) and from baseline (Day 1) to postvaccination with PCV15 + PPSV2 (Week 12) for OPA responses, Serotype-specific GMFRs from baseline (Day 1) to postvaccination with V116 (Day 30) and from baseline (Day 1) to postvaccination with PCV15 + PPSV23 (Week 12) for IgG responses, Serotype-specific proportion of participants with a ≥4-fold rise from baseline (Day 1) to postvaccination with V116 (Day 30) and from baseline (Day 1) to postvaccination with PCV15 + PPSV2 (Week 12) for OPA responses, Serotype-specific proportion of participants with a ≥4-fold rise from baseline (Day 1) to postvaccination with V116 (Day 30) and from baseline (Day 1) to postvaccination with PCV15 + PPSV2 (Week 12) for IgG responses

Source: https://euclinicaltrials.eu/ctis-public/view/2022-502791-22-01